EU clinical trial 2025-521971-29-00: A Phase 3 Multicenter Double-blind Randomized Study of Taletrectinib Versus Placebo in Patients With ROS1-Fusion Positive Stage IB-IIIA Non-Small Cell Lung Cancer Who Have Undergone Complete Tumor Resection
Protocol code: AB-106-G319
Sponsor: Nuvation Bio Inc. (Pharmaceutical company). Phase: Therapeutic confirmatory (Phase III). Countries: Spain (authorised, recruitment pending), Belgium (authorised, recruitment pending), France (authorised, recruitment pending), Italy (authorised, recruitment pending), Germany (authorised, recruitment pending).
Therapeutic area(s): Diseases [C] - Neoplasms [C04]; Diseases [C] - Respiratory Tract Diseases [C08]
Gender: Female, Male. Age: 18-64 years, 65+ years. Enrolment: 45.
Status: Authorised, recruitment pending. Decision date: 2026-06-30. Results received: No. Last updated: 2026-07-03.
Decision dates by country: BE: 2026-06-30, FR: 2026-06-30, DE: 2026-07-02, IT: 2026-07-01, ES: 2026-07-03

Condition(s): Non Small Cell Lung Cancer (NSCLC)
Product: Taletrectinib, Taletrectinib, Placebo matching Taletrectinib capsules

Primary endpoint: DFS by Investigator assessment
Endpoint(s): 1 DFS rates by Investigator assessment at 2, 3, 4, and 5 years., 2 Overall survival (OS), 3 DFS by blinded independent central review (BICR)., 4 OS rates at 2, 3, 4, and 5 years., 5 Central nervous system (CNS) DFS by Investigator assessment and by BICR., 6 Plasma concentrations of taletrectinib., 7 Adverse events (AEs), as graded by Common Terminology Criteria for Adverse Events (CTCAE) v5.0; laboratory abnormalities as graded by CTCAE v5.0; vital signs, physical examinations, and digital electrocardiograms (ECGs).

Source: https://euclinicaltrials.eu/ctis-public/view/2025-521971-29-00